EU clinical trial 2025-524769-26-00: FINACCESS - Finnish National Study for Early Access to Cancer Therapies
Sponsor: HUS-yhtymae (Hospital/Clinic/Other health care facility). Phase: Therapeutic exploratory (Phase II). Countries: Finland (authorised, recruiting).
Therapeutic area(s): Diseases [C] - Neoplasms [C04]
Gender: Female, Male. Age: 18-64 years, 65+ years. Enrolment: 1500.
Status: Authorised, recruiting. Start date (EU): 2026-06-30. Decision date: 2026-05-08. Results received: No. Last updated: 2026-05-11.

Condition(s): Cancer
Product: BI 1810631

Primary endpoint: To evaluate the anti-tumor activity and toxicity of anti-cancer drugs that are approved or under review for approval by EMA, FDA or PMDA, or for which otherwise sufficient safety data has been established, and are used for the treatment of patients with cancer.
Endpoint(s): To perform optional biomarker analyses including (but not limited to) next generation sequencing on fixed and fresh tumor samples or liquid biopsies, To define possible pathway activations and resistance mechanism facilitating progression to given therapies

Source: https://euclinicaltrials.eu/ctis-public/view/2025-524769-26-00